EU clinical trial 2024-514031-20-00: AZALEA: A Phase II study of atezolizumab, vinorelbine and weekly cyclophosphamide as T-cell activators in first line metastatic triple negative breast cancer patients pre-treated with anti-PD-L1/PD-1
Sponsor: Istituto Europeo Di Oncologia S.r.l. (Hospital/Clinic/Other health care facility). Phase: Therapeutic exploratory (Phase II). Countries: Italy (ongoing, recruiting).
Therapeutic area(s): Diseases [C] - Neoplasms [C04]
Gender: Female, Male. Age: 18-64 years, 65+ years. Enrolment: 45.
Status: Ongoing, recruiting. Start date (EU): 2025-02-24. Decision date: 2024-08-07. Results received: No. Last updated: 2026-04-08.

Condition(s): Inoperable locally advanced or metastatic TNBC patients, previously treated with anti-PD-L1/PD1- regimens
Product: CYCLOPHOSPHAMIDE MONOHYDRATE, VINORELBINE, Tecentriq 840 mg concentrate for solution for infusion

Primary endpoint: overall response rate
Endpoint(s): Duration of response (DOR), Progression-free survival (PFS), Overall survival (OS), Safety of the combination regimen

Source: https://euclinicaltrials.eu/ctis-public/view/2024-514031-20-00